EU clinical trial 2024-514896-17-00: AUDIOWOLF: A phase II, open-label, efficacy study of daily administration of sodium valproate in patients clinically affected by Wolfram syndrome due to monogenic mutation
Protocol code: 2020-004594-43
Sponsor: Centre D'Etude Des Cellules Souches (Pharmaceutical company). Phase: Therapeutic exploratory (Phase II). Countries: France (ended), Spain (ended).
Therapeutic area(s): Diseases [C] - Congenital, Hereditary, and Neonatal Diseases and Abnormalities [C16]
Gender: Female, Male. Age: 0-17 years, 18-64 years. Enrolment: 23.
Status: Ended. Start date (EU): 2021-10-08. End date (EU): 2025-09-16. Decision date: 2024-11-19. Results received: No. Last updated: 2025-07-31.
Decision dates by country: FR: 2024-11-19, ES: 2024-11-19

Condition(s): Wolfram syndrom
Product: DEPAKINE CHRONO 500 mg, comprimé pelliculé sécable à libération prolongée

Primary endpoint: Preservation of auditory function defined as no decrease higher than 5 dB in hearing at 8 kHz in high frequency average (HFA) over three years, assessed by audiometry tests (PTA) and High frequency pure tone audiometry hearing test (HFPTA) in patients with Wolfram syndrome with a deficit of at least 20d dB at 8 kHz treated with VPA at optimal dose corresponding to the plasma level between 40 and 100 mg/l (i.e., 300 to 700 micro mol/l).
Endpoint(s): Safety: Overall incidence of adverse events and serious adverse events, patient withdrawals as well as changes from baseline in laboratory safety assessments and vital signs parameters will be evaluated for each group and for the study as a whole., Efficacy: Ventral Pons Volume measured and recorded in mm3 by standardised analysis of MRI at baseline, at visit 6 (Week 52) and at the last visit, Efficacy: Insulin and or desmopressin requirements will be assessed whenever the patient is under one or both treatments in order to document potential benefit from VPA on diabetes mellitus or diabetes insipidus, Efficacy: Visual acuity will be assessed using standard ETDRS measures and visual field recording at baseline, every six months during the first year of follow-up and at the final visit, Efficacy: Retinal nerve thickness measure by OCT measures at baseline, every six months during the first year of follow-up and at the final visit, Efficacy: Balance, measured by Mini-BESTest (Appendix 1) at baseline, at visit 6 (Week 52) and at the final visit, Efficacy: Sleep will be investigated by a specific Sleep questionnaire at baseline, at visit 6 (Week 52) and final visit, for patients under 18 years: sleeping habits measured by the Pediatric Sleep Questionnaire (PSQ) Parent Questionnaire, and for adults: sleeping habits, measured by the Pittsburg Sleep Quality Index (PSQI) Self-Report

Source: https://euclinicaltrials.eu/ctis-public/view/2024-514896-17-00